EU clinical trial 2022-502461-23-00: INCB 18424-320: A phase 3, double-blind, randomised, vehicle-controlled, efficacy and safety study of ruxolitinib cream in participants with Prurigo Nodularis. Topical ruxolitinib evaluation in Prurigo Nodularis (TRuE-PN2)
Protocol code: INCB18424-320
Sponsor: Incyte Corp. (Pharmaceutical company). Phase: Therapeutic confirmatory (Phase III). Countries: Austria (ended), Poland (ended), Spain (ended), France (ended), Bulgaria (ended), Germany (ended), Denmark (ended), Italy (ended).
Therapeutic area(s): Diseases [C] - Skin and Connective Tissue Diseases [C17]; Diseases [C] - Immune System Diseases [C20]
Gender: Female, Male. Age: 18-64 years, 65+ years. Enrolment: 117.
Status: Ended. Start date (EU): 2024-02-15. End date (EU): 2025-11-04. End date: 2025-11-04. Decision date: 2024-01-19. Results received: No. Last updated: 2025-07-10.
Decision dates by country: FR: 2024-01-19, DK: 2024-05-01, BG: 2024-01-24, PL: 2024-06-12, AT: 2024-01-29, ES: 2024-01-29, IT: 2024-01-30, DE: 2024-01-23

Condition(s): Prurigo Nodularis
Product: Vehicle cream (same formulation of cream as the test product but without active substance), Ruxolitinib (INCB018424) cream

Primary endpoint: WI-NRS4 response at Week 12, defined as achieving a ≥ 4-point improvement (reduction) in WI-NRS score from baseline.
Endpoint(s): WI-NRS4 response at Week 4., Overall-TS at Week 12, defined as achieving both a WI-NRS4 response and an IGA-CPG-S TS. (IGA-CPG-S-TS is defined as an IGA-CPG-S score of 0 or 1 with a ≥ 2 grade improvement from baseline), IGA-CPG-S-TS at Week 12., WI-NRS4 response on Day 7.

Source: https://euclinicaltrials.eu/ctis-public/view/2022-502461-23-00